EU clinical trial 2025-524336-19-00: A Phase 3, Randomized, Open-label Study to Evaluate the Efficacy and Safety of Switching to a Regimen of Broadly Neutralizing Antibodies Teropavimab and Zinlirvimab in Combination with Capsid Inhibitor Lenacapavir Twice Yearly in Virologically Suppressed Adults with HIV-1 Infection on Stable Oral Treatment Regimens
Protocol code: GS-US-536-6544
Sponsor: Gilead Sciences Inc. (Pharmaceutical company). Phase: Therapeutic confirmatory (Phase III). Countries: Poland (authorised, recruitment pending), Italy (authorised, recruitment pending), France (authorised, recruitment pending), Spain (authorised, recruitment pending), Germany (authorised, recruitment pending), Netherlands (authorised, recruitment pending).
Therapeutic area(s): Diseases [C] - Virus Diseases [C02]
Gender: Female, Male. Age: 18-64 years, 65+ years. Enrolment: 183.
Status: Authorised, recruitment pending. Decision date: 2026-07-21. Results received: No. Last updated: 2026-07-27.
Decision dates by country: FR: 2026-07-27, DE: 2026-07-24, IT: 2026-07-23, ES: 2026-07-24, NL: 2026-07-21, PL: 2026-07-23

Condition(s): HIV-1
Product: Tybost 150 mg film-coated tablets, Tivicay 50 mg film-coated tablets, INTELENCE 200 mg tablets, Sunlenca 464 mg solution for injection, Emtriva 200 mg hard capsules, ISENTRESS 400 mg film-coated tablets, EFAVIRENZ VIATRIS 600 mg, comprimé pelliculé, REYATAZ 200 mg hard capsules, REKAMBYS 600 mg prolonged-release suspension for injection, Ziagen 300 mg film-coated tablets, Pifeltro 100 mg film-coated tablets, Sunlenca 300 mg film-coated tablets, Norvir 100 mg powder for oral suspension, Epivir 150 mg film-coated tablets, Genvoya 90 mg/90 mg/120 mg/6 mg film-coated tablets, GS-5423, REZOLSTA 800 mg/150 mg film-coated tablets, Aptivus 250 mg soft capsules, GS-2872, Viread 123 mg film-coated tablets

Primary endpoint: Proportion of participants with HIV-1 RNA ≥ 50 copies/mL at Week 52 as defined by the US FDA snapshot algorithm.
Endpoint(s): Proportion of participants with HIV-1 RNA ≥ 50 copies/mL at Week 92 as defined by the US FDA snapshot algorithm., Proportion of participants with HIV-1 RNA < 50 copies/mL at Weeks 52 and 92 as determined by the US FDA snapshot algorithm., Changes from baseline in CD4+ T-cell counts at Weeks 52 and 92., Proportion of participants experiencing TEAEs., Proportion of participants prematurely discontinuing their study treatment due to an AE., Trough concentrations at Weeks 26, 52, and 104 for LEN, TAB, and ZAB., Incidence of ADAs and neutralizing antibodies (NAbs) of TAB and ZAB.

Source: https://euclinicaltrials.eu/ctis-public/view/2025-524336-19-00